EU clinical trial 2023-506018-35-00: Rapid intravenous infusion of 10 and 22 degrees Celcius Ringer's lactate in healthy volunteers and its effects on circulation and hemostasis - a randomized crossover trial
Protocol code: SVS.FAM.02
Sponsor: Sydvestjysk Sygehus (Hospital/Clinic/Other health care facility). Phase: Human Pharmacology (Phase I)- Other. Countries: Denmark (ended).
Therapeutic area(s): Phenomena and Processes [G] - Circulatory and Respiratory Physiological Phenomena [G09]
Gender: Female, Male. Age: 18-64 years. Enrolment: 25.
Status: Ended. Start date (EU): 2023-11-06. End date (EU): 2023-12-20. Decision date: 2023-09-08. Results received: Yes. Last updated: 2024-01-25.

Condition(s): Hemodynamic parameters is to be investigated -- comparing cold fluids 10 degrees celsius to room temperature 22 degrees celsius
Product: Ringer-lactat Fresenius Kabi

Primary endpoint: The primary outcome of the study is the increase in mean arterial pressure (MAP) 30 minutes after started infusion of the fluid bolus measured via standard non-invasive blood pressure cuff.
Endpoint(s): Time until return of MAP to baseline value after infusion., Changes in VAS during infusion, Changes in temperature, blood pressure, heart rate, peripheral oxygen saturation cardiac index, cardiac output, total peripheral resistance index, and stroke volume, Changes in the intravascular volume status and fluid responsiveness, Changes in biochemical parameters at baseline, 30 and 60 minutes, Changes in ROTEM analysis at baseline, 30 and 60 minutes

Source: https://euclinicaltrials.eu/ctis-public/view/2023-506018-35-00